EU clinical trial 2023-505569-95-00: A Phase 4, Open-Label, Non-randomised, Multicentre Study to Evaluate Safety and Efficacy of Intravenous Administration of Sonazoid™ for Contrast-Enhanced Ultrasound Liver Imaging in Paediatric Patients.
Protocol code: GE-045-401
Sponsor: GE Healthcare Limited (Pharmaceutical company). Phase: Phase III and phase IV (Integrated). Countries: Italy (authorised, recruitment pending), Germany (authorised, recruitment pending).
Therapeutic area(s): Analytical, Diagnostic and Therapeutic Techniques and Equipment [E] - Diagnosis [E01]
Gender: Female, Male. Age: 0-17 years. Enrolment: 30.
Status: Authorised, recruitment pending. Decision date: 2025-07-21. Results received: No. Last updated: 2025-11-06.
Decision dates by country: DE: 2025-07-22, IT: 2025-07-21

Condition(s): Focal Liver Lesion
Product: PERFLUBUTANE, PHOSPHOLIPID MICROSPHERES

Primary endpoint: The accuracy, sensitivity and specificity of the diagnosis based on the independent blinded read of the Sonazoid™-enhanced imaging for lesion differentiation (benign or malignant FLLs) during vascular phase imaging. The WFUMB-EFSUMB guidelines for interpreting CEUS of the liver in adults shall be used for interpreting the images and the subject’s baseline diagnosis (well-established by CECT, CEMRI or biopsy) will be used as the reference diagnosis/standard of truth.
Endpoint(s): Accuracy, sensitivity and specificity of the diagnosis (benign or malignant FLL) based on the Sonazoid™-enhanced imaging by vascular phase imaging, as compared with the unenhanced ultrasound imaging, when the baseline diagnosis is used as the reference standard., Accuracy, sensitivity and specificity of the diagnosis (benign or malignant FLL) based on the Sonazoid™-enhanced imaging by vascular phase and Kupffer phase imaging, as compared with the unenhanced ultrasound imaging, when the baseline diagnosis is used as the reference standard., The difference in the diagnostic confidence score for the unenhanced ultrasound imaging and that for the Sonazoid™-enhanced ultrasound imaging based on the vascular phase., Exploratory outcome measure: The difference in the diagnostic confidence score for the unenhanced ultrasound imaging and that for the Sonazoid™-enhanced ultrasound imaging based on the vascular and Kupffer phase., Exploratory outcome measure: CEUS specific FLL diagnosis throughout the vascular phase of imaging and the vascular and Kupffer phases of imaging according to WFUMB-EFSUMB guidelines (HCC, metastasis, haemangioma, FNH, focal fatty infiltration, focal fatty sparing) observed in paediatric patients., Safety outcome measure: Treatment-emergent AEs (TEAEs) defined as AEs that occurred at any timepoint from the administration of Sonazoid™ to the end of the study (72 hours after Sonazoid™ administration), including drug-related TEAEs, Safety outcome measure: Serious AEs (SAEs), Safety outcome measure: Physical examination, vital signs, blood and urine samples for clinical laboratory testing and injection site monitoring

Source: https://euclinicaltrials.eu/ctis-public/view/2023-505569-95-00